EU clinical trial 2025-521644-37-00: DEPECA-1 – DEfeating PEnile CAncer 1 – A Phase II study to evaluate a first-line systemic therapy with enfortumab vedotin plus avelumab for advanced and metastatic penile carcinoma
Protocol code: UKT-IKF-DEPECA-1
Sponsor: Frankfurter Institut Fuer Klinische Krebsforschung IKF GmbH (Pharmaceutical company). Phase: Therapeutic exploratory (Phase II). Countries: Germany (ongoing, recruiting).
Therapeutic area(s): Diseases [C] - Neoplasms [C04]; Diseases [C] - Male Urogenital Diseases [C12]
Gender: Male. Age: 18-64 years, 65+ years. Enrolment: 25.
Status: Ongoing, recruiting. Start date (EU): 2025-11-28. Decision date: 2025-10-29. Results received: No. Last updated: 2026-03-25.

Condition(s): locally advanced or metastatic penile squamous cell carcinoma
Product: Padcev 30 mg powder for concentrate for solution for infusion, Bavencio 20 mg/mL concentrate for solution for infusion

Primary endpoint: Objective Response Rate (ORR) in 1st line as assessed by investigators, defined as the proportion of patients achieving a complete response (CR) or partial response (PR) according to RECIST 1.1 criteria.
Endpoint(s): Progression-free survival (PFS), defined as the time from the start of treatment to the first documented disease progression acc. to RECIST 1.1 criteria or death from any cause, whichever occurs first., Overall Survival (OS), defined as the time from the start of treatment to death from any cause., Duration of Response (DoR), defined as the time from the first documented response (CR or PR) to disease progression or death from any cause, whichever occurs first., Disease Control Rate (DCR), defined as the proportion of patients achieving CR, PR, or stable disease (SD) according to RECIST 1.1 criteria., Incidence and severity of adverse events (AEs) and serious adverse events (SAEs), graded according to the Common Terminology Criteria for Adverse Events (CTCAE) version 5.0., Changes in patient-reported quality of life, using EQ-5D-5L and EQ-HWB-S questionnaire and a set of bolt-on questions will be collected.

Source: https://euclinicaltrials.eu/ctis-public/view/2025-521644-37-00